EU clinical trial 2024-515387-31-00: Mesenchymal stem cells for Angiogenesis and Neovascularisation in digital Ulcers of Systemic sclerosis: the MANUS Trial
Sponsor: Universitair Medisch Centrum Utrecht (Hospital/Clinic/Other health care facility). Phase: Therapeutic exploratory (Phase II). Countries: Netherlands (ongoing, recruiting).
Therapeutic area(s): Diseases [C] - Skin and Connective Tissue Diseases [C17]; Diseases [C] - Immune System Diseases [C20]
Gender: Female, Male. Age: 18-64 years, 65+ years. Enrolment: 20.
Status: Ongoing, recruiting. Start date (EU): 2024-11-01. Decision date: 2024-10-29. Results received: No. Last updated: 2024-10-29.

Condition(s): Systemic Sclerosis
Product: Mesenchymal stem cells, Suspension and solvent for suspension for injection

Primary endpoint: The primary outcome is the toxicity of the treatment at 12 weeks after MSC administration, defined as -1. Local toxicity, including signs of local inflammation (swelling, warmth, impairment of function), worsening of ulcers or new ulcers or hematomes after MSC administration - 2. Other adverse events, graded according to the Common Terminology Criteria for Adverse Events.
Endpoint(s): A secondary outcome measure for safety is the incidence (at 12 weeks post treatment) of any treatment-related serious adverse events (SAE) defined as events leading to hospitalization, death, or persistent or significant disability, Change in pain as assessed using the Numerical Rating Scale, the digital ulcer visual analogue scale (part of the S-HAQ), pain VAS (S-HAQ), use of analgesics., Quality of life and disability as assessed with the HAQ-disability index, and the SF-36, EuroQol (EQ-5D) questionnaires, Hand function as assessed with the Cochin Hand Function Scale., Number of digital ulcers 12 weeks post treatment, Change in the number of active tip digital ulcers on the volar aspect, Need to alter medication regime as determined by the patient’s own rheumatologist, The severity of scleroderma as assessed with the Modified Rodnan skin score 79 and the Scleroderma Health Assessment Questionnaire (S-HAQ), Number and severity of Raynaud’s symptoms, as assessed using the Raynaud Condition Score, Changes in capillary morphology and architecture, as visualized with video-assisted nailfold capillaroscopy by a trained investigator, Changes in laboratory parameters

Source: https://euclinicaltrials.eu/ctis-public/view/2024-515387-31-00